EU clinical trial 2024-510750-28-00: Phase 2 study of neoadjuvant immune checkpoint inhibitors in urothelial cancer (ABACUS-2)
Protocol code: ABACUS-2
Sponsor: Queen Mary University Of London (Educational Institution). Phase: Therapeutic exploratory (Phase II). Countries: Spain (ended), France (ongoing, recruitment ended).
Therapeutic area(s): Diseases [C] - Neoplasms [C04]
Gender: Female, Male. Age: 18-64 years, 65+ years. Enrolment: 30.
Start date (EU): 2021-06-18. Decision date: 2024-09-20. Results received: No. Last updated: 2024-11-20.
Decision dates by country: ES: 2024-09-23, FR: 2024-09-20

Condition(s): Tumours of the urothelial tract requiring surgery (T1 high grade-T4a of the bladder, rare histological subtypes) and upper urinary tract (high grade or high risk)
Product: Tecentriq 1 200 mg concentrate for solution for infusion

Primary endpoint: This study has a clinical and a biological primary endpoint: Clinical: • Bladder Cohort rare histological subtypes: To assess the efficacy of atezolizumab pre-cystectomy with respect to pCR rate in patients with carcinoma of the urothelium of the bladder (T1 high grade-T4aN0-1M0) with mixed or rare histological subtypes • UTUC Cohort: To assess the efficacy of atezolizumab pre-surgery with respect to pCR rate in patients with high grade or high risk (N0-1M0) upper urinary tract urothelial ca
Endpoint(s): 1).To evaluate the safety and tolerability of atezolizumab when given in neoadjuvant treatment, 2) To assess the efficacy of atezolizumab given in the neoadjuvant setting before radical surgery with respect to anti-tumour effects as measured by Investigator assessed radiological response (RR)., 3) To assess the efficacy of atezolizumab given in the neoadjuvant setting before radical surgery with respect to antitumour effects based on Investigator assessed disease-free survival (DFS)., 4) To assess the efficacy of atezolizumab given in the neoadjuvant setting before radical surgery with respect to overall survival (OS).

Source: https://euclinicaltrials.eu/ctis-public/view/2024-510750-28-00